EU clinical trial 2024-513116-10-00: Randomized, double-blind, placebo-controlled Phase I study in healthy individuals on autotaxin-inhibition with MJK2134025 in single-ascending, as well as multiple intravenous doses
Protocol code: 24-00053
Sponsor: Universitaetsmedizin der Johannes Gutenberg-Universitaet Mainz KöR (Hospital/Clinic/Other health care facility). Phase: Human Pharmacology (Phase I)- First administration to humans. Countries: Germany (ongoing, recruiting).
Therapeutic area(s): Not possible to specify
Gender: Male. Age: 18-64 years. Enrolment: 70.
Status: Ongoing, recruiting. Start date (EU): 2025-03-31. Decision date: 2025-03-18. Results received: No. Last updated: 2026-08-03.
Decision dates by country: DE: 2025-04-30

Condition(s): Stroke

Source: https://euclinicaltrials.eu/ctis-public/view/2024-513116-10-00